EU clinical trial 2022-502700-78-00: I4V-MC-JAIO: A Phase 3, Double-Blind, Randomized, Placebo-Controlled Trial to Evaluate the Efficacy, Safety, and Pharmacokinetics of Baricitinib in Children from 6 Years to less than 18 Years of Age with Alopecia Areata
Protocol code: I4V-MC-JAIO
Sponsor: Eli Lilly & Co. (Pharmaceutical company). Phase: Therapeutic confirmatory (Phase III). Countries: France (ongoing, recruitment ended), Poland (ongoing, recruitment ended), Spain (ongoing, recruitment ended), Hungary (ongoing, recruitment ended), Germany (ongoing, recruitment ended).
Therapeutic area(s): Diseases [C] - Skin and Connective Tissue Diseases [C17]
Gender: Female, Male. Age: 0-17 years. Enrolment: 414.
Status: Ongoing, recruitment ended. Start date (EU): 2023-09-01. Decision date: 2023-08-28. Results received: No. Last updated: 2026-08-07.
Decision dates by country: PL: 2023-08-30, HU: 2023-08-30, DE: 2023-10-23, ES: 2023-08-28, FR: 2023-08-29

Condition(s): Alopecia areata (AA)
Product: BARICITINIB, Baricitinib, BARICITINIB, A placebo to match LY3009104, BARICITINIB

Primary endpoint: Percentage of participants achieving an absolute Severity of Alopecia Tool (SALT) ≤ 20

Source: https://euclinicaltrials.eu/ctis-public/view/2022-502700-78-00